EU clinical trial 2024-514409-78-01: INFORM2 exploratory multinational phase I/II combination study of Nivolumab and Entinostat in children and adolescents with refractory high-risk malignancies (INFORM2-NivEnt)
Protocol code: INFORM2-NivEnt
Sponsor: Universitaetsklinikum Heidelberg AöR (Hospital/Clinic/Other health care facility). Phase: Phase I and Phase II (Integrated)- Other. Countries: Austria (ongoing, recruitment ended), Sweden (ongoing, recruitment ended), Germany (ongoing, recruitment ended), Netherlands (ongoing, recruitment ended), France (ongoing, recruitment ended).
Therapeutic area(s): Diseases [C] - Neoplasms [C04]
Gender: Female, Male. Age: 0-17 years, 18-64 years. Enrolment: 59.
Status: Ongoing, recruitment ended. Start date (EU): 2019-07-26. Decision date: 2024-11-19. Results received: No. Last updated: 2026-07-08.
Decision dates by country: NL: 2024-11-22, SE: 2024-11-19, DE: 2024-11-21, AT: 2024-11-26, FR: 2024-11-22

Condition(s): relapsed / refractory or progressive high risk malignant disease
Product: OPDIVO 10 mg/mL concentrate for solution for infusion., ENTINOSTAT, ENTINOSTAT

Primary endpoint: Phase I: Dose Limiting Toxicity (DLT) of the combination treatment, Phase II: Best response (CR or PR) will be based on RANO criteria for all primary CNS tumors and RECIST for non-CNS tumors, defined for each patient as the best response under study combination therapy during the first 6 cycles by central review. Calcified or intra-osseous (osteo)sarcoma target lesions which were progressive before initiation of treatment and show SD on response evaluation will be considered as a responder.

Source: https://euclinicaltrials.eu/ctis-public/view/2024-514409-78-01